EU clinical trial 2023-507285-24-00: Non-inferiority Clinical Trial for Comparing the Efficacy and Tolerability of a new fixed-Combination Generic Formulation of Brimonidine 0.2%/Timolol 0.5% eye drops, solution in single-dose containers vs Combigan® eye drops, solution in Patients with Open Angle Glaucoma or Ocular Hypertension
Protocol code: BECRO/PS/ETHRA
Sponsor: Becro (Cyprus) Limited (Industry). Phase: Therapeutic confirmatory (Phase III). Countries: Greece (ended).
Therapeutic area(s): Diseases [C] - Eye Diseases [C11]
Gender: Female, Male. Age: 18-64 years, 65+ years. Enrolment: 180.
Status: Ended. Start date (EU): 2024-05-31. End date (EU): 2025-02-06. Decision date: 2024-03-22. Results received: Yes. Last updated: 2024-03-22.

Condition(s): Open angle glaucoma is characterized by increased intraocular pressure, resulting in pathological changes in the optic disk and typical visual field defects,and eventually blindness
Product: Combigan 2 mg/ml + 5 mg/ml Augentropfen, Brimonidine 2 mg/ml + Timolol 5mg/ml eye drops solution in single-dose container

Primary endpoint: Change in IOP at 08:00 in study eye from end of treatment (week 12) to baseline (week 0) in subjects treated with the test product as compared to subjects treated with the reference product
Endpoint(s): Change in IOP at 12:00 and 16:00 in study eye from end of treatment (week 12) to baseline (week 0) in subjects treated with the test product as compared to subjects treated with the reference product., Change in IOP at 08:00, 12:00 and 16:00 in study eye from week 2 to baseline (week 0) in subjects treated with the test product as compared to subjects treated with the reference product., Change in IOP at 08:00, 12:00 and 16:00 in study eye from week 6 to baseline (week 0) in subjects treated with the test product as compared to subjects treated with the reference product, Average diurnal IOP change from baseline to end of week 12, Average decrease of diurnal IOP measured between baseline and week 2., Average decrease of diurnal IOP measured between baseline and week 6, Proportion of withdrawals for therapeutic failure (diurnal IOP ≥22 mmHg) at any time point during or at the end of week 12.

Source: https://euclinicaltrials.eu/ctis-public/view/2023-507285-24-00